EU clinical trial 2023-508249-42-00: ORal antibiotics In Acute Mesenteric Ischemia: a multicenter randomized
Protocol code: APHP220818
Sponsor: Assistance Publique Hopitaux De Paris (Hospital/Clinic/Other health care facility). Phase: Therapeutic confirmatory (Phase III). Countries: France (ongoing, recruiting).
Therapeutic area(s): Diseases [C] - Digestive System Diseases [C06]
Gender: Female, Male. Age: 18-64 years, 65+ years. Enrolment: 196.
Status: Ongoing, recruiting. Start date (EU): 2026-05-19. Decision date: 2024-07-23. Results received: No. Last updated: 2026-05-18.

Condition(s): Acute mesenteric ischemia
Product: GENTAMICINE PANPHARMA 80 mg, solution injectable, Gentamicin Placebo, Metronidazole Biogaran 500 mg Placebo, Natriumchlorid-Lösung 0,9 % Deltamedica, Injektionslösung, METRONIDAZOLE BIOGARAN 500 mg, comprimé pelliculé

Primary endpoint: Occurrence of intestinal necrosis or death within 30 days following randomisation defined by the following criteria histology assessment OR all-cause mortality within 30 days following randomisation
Endpoint(s): Oral antibiotics impact assessment endpoints a. occurrence of intestinal necrosis within the 30 days following the randomisation. b. vital status at day-30 after the randomisation c. short bowel syndrome at day-30 after the randomisation d. total length of intestinal resection at day 30 following the randomisation e. occurrence of organ failure within the 30 days following the randomisation f. number of days in the intensive care unit g. number of hospitalization days, Safety endpoints a. Occurrence of minor side effects b. Occurrence of hypersensitivity reaction to antibiotics c. Occurrence of other adverse events d. Emergence of antimicrobial-resistant microorganisms e. Occurrence of healthcare-associated infection, Antibiotics’ pharmacokinetic and blood concentration endpoints: a. Blood levels of gentamicin at randomisation day , days 7 and 14 after randomisation b. Blood levels of metronidazole at randomisation day, days 7 and 14 after randomisation

Source: https://euclinicaltrials.eu/ctis-public/view/2023-508249-42-00